EU clinical trial 2023-507396-21-00: An open-label, dose-escalation, dose-finding, and proof-of-concept trial of SP-420 in subjects with transfusion-dependent α- or β-thalassemia or low-risk myelodysplastic syndromes
Protocol code: P-SP420-THAL-01
Sponsor: Pharmacosmos A/S (Pharmaceutical company). Phase: Therapeutic exploratory (Phase II). Countries: Denmark (ongoing, recruiting), Greece (ongoing, recruiting), Italy (ongoing, recruiting), Poland (ongoing, recruiting).
Therapeutic area(s): Diseases [C] - Hemic and Lymphatic Diseases [C15]
Gender: Female, Male. Age: 18-64 years. Enrolment: 102.
Status: Ongoing, recruiting. Start date (EU): 2023-03-16. Decision date: 2024-06-13. Results received: No. Last updated: 2026-08-04.
Decision dates by country: DK: 2024-06-13, PL: 2026-03-07, IT: 2024-07-03, GR: 2024-08-28

Condition(s): transfusion-dependent α- or β-thalassemia or low-risk myelodysplastic syndromes

Primary endpoint: 1. Thalassemia cohorts - 1. Primary efficacy endpoint: Total body iron removed by SP-420 from baseline to week 24, 2. MDS cohorts - 1. Primary safety endpoint: Type and incidence of AEs after 12 weeks of treatment
Endpoint(s): 1. Thalassemia cohorts 1. Key-secondary efficacy endpoints 1: Total body iron removed by SP-420 from baseline to week 24 (pairwise treatment group comparison), 1. Thalassemia cohorts 2. Secondary efficacy endpoints 1: Change in liver iron concentration (LIC) measured by R2- magnetic resonance imaging (MRI) from baseline to weeks 12, 24 and 48, 1. Thalassemia cohorts 3. Secondary efficacy endpoints 2: Total body iron removed by SP-420 from baseline to week 12 and week 48, and from week 24 to week 48, 1. Thalassemia cohorts 4. Secondary efficacy endpoints 3: Change in s-ferritin from baseline to weeks 1, 2, 3, 4, 6, 8, 12, 16, 20, 24, 28, 32, 36, 40, 44, and 48, 1. Thalassemia cohorts 5. Secondary safety endpoints 1: Type and incidence of adverse events (AEs), 2. MDS cohorts - 1. Secondary safety endpoints: Type and incidence of AEs; Left ventricular ejection fraction (LVEF) at weeks 24 and 48, 2. MDS cohorts - 2. Secondary efficacy endpoints: Change in s-ferritin from baseline to weeks 1, 2, 3, 4, 6, 8, 12, 16, 20, 24, 32, 40, and 48

Source: https://euclinicaltrials.eu/ctis-public/view/2023-507396-21-00